EU clinical trial 2026-525933-22-00: STRategiEs for Antiplatelet Management foLlowIng acute coroNary syndromE (STREAMLINE)
Sponsor: Instituto De Investigacion Sanitaria Fundacion Jimenez Diaz (Laboratory/Research/Testing facility). Phase: Therapeutic use (Phase IV). Countries: Spain (authorised, recruitment pending), Norway (authorised, recruitment pending).
Therapeutic area(s): Diseases [C] - Cardiovascular Diseases [C14]
Gender: Female, Male. Age: 18-64 years, 65+ years. Enrolment: 3500.
Status: Authorised, recruitment pending. Decision date: 2026-07-28. Results received: No. Last updated: 2026-07-30.
Decision dates by country: NO: 2026-07-28, ES: 2026-07-30

Condition(s): ischemic heart disease
Product: PRASUGREL, ACETYLSALICYLIC ACID, TICAGRELOR

Primary endpoint: Incidence of the composite “all-cause mortality, non-fatal MI or stroke” at 12 months follow up., Safety Endpoint 1. Incidence of major bleeding at 12 months. This will be defined as bleeding academic research consortium scale (BARC) graded 3a to 5.
Endpoint(s): The incidence of the individual components of the primary composite., Death from cardiovascular causes, A composite of net adverse clinical benefit, including all-cause mortality, non-fatal MI or stroke and the incidence of BARC 3-5 bleeding at 12 months., Unplanned revascularization. This will include revascularization procedures that were not Preplanned during index hospitalization, BARC 2-5 bleeding at 12 months

Source: https://euclinicaltrials.eu/ctis-public/view/2026-525933-22-00